EU clinical trial 2024-520117-50-00: A Phase 2b, Multicenter, Randomized, Double-blinded, Placebo-controlled, Parallel-group, Dose-finding Study to Evaluate the Efficacy and Safety of IMG-007 in Adult Participants with Moderate-to-Severe Atopic Dermatitis
Protocol code: IMG-007-203
Sponsor: Inmagene LLC (Pharmaceutical company). Phase: Therapeutic exploratory (Phase II). Countries: Czechia (authorised, recruitment pending), Spain (authorised, recruitment pending), Germany (authorised, recruitment pending), Hungary (authorised, recruitment pending), Poland (authorised, recruitment pending).
Therapeutic area(s): Diseases [C] - Immune System Diseases [C20]
Gender: Female, Male. Age: 18-64 years, 65+ years. Enrolment: 132.
Status: Authorised, recruitment pending. Decision date: 2025-09-24. Results received: No. Last updated: 2025-09-30.
Decision dates by country: CZ: 2025-09-24, DE: 2025-09-26, HU: 2025-09-29, PL: 2025-09-30, ES: 2025-09-25

Condition(s): Atopic Dermatitis

Primary endpoint: Mean percent change from baseline in EASI at Week 20
Endpoint(s): • Mean percent change from baseline in EASI at Week 16, • Proportion of participants achieving a ≥ 75% reduction in EASI (EASI-75) at Week 16 and Week 20, respectively, • Proportion of participants achieving a vIGA-AD score of 0 (clear) or 1 (almost clear) and a ≥ 2-point reduction from baseline at Week 16 and Week 20, respectively, • Incidence and severity of TEAE including treatment-emergent SAEs

Source: https://euclinicaltrials.eu/ctis-public/view/2024-520117-50-00